EU clinical trial 2024-519661-22-00: Randomized, crossover, comparative bioavailability study of two Paracetamol-Ibuprofen 25-20 mg/ml oral suspension, administered in single dose to healthy subjects under fasting conditions.
Protocol code: FMLD-UMBRIA-62
Sponsor: Farmalider S.A. (Pharmaceutical company). Phase: Human Pharmacology (Phase I)- Other. Countries: Spain (ended).
Therapeutic area(s): Not possible to specify
Gender: Female, Male. Age: 18-64 years. Enrolment: 24.
Status: Ended. Start date (EU): 2025-03-03. End date (EU): 2025-04-23. Decision date: 2025-02-18. Results received: No. Last updated: 2025-02-18.

Condition(s): Healthy volunteers

Source: https://euclinicaltrials.eu/ctis-public/view/2024-519661-22-00